EU clinical trial 2023-509490-23-00: OPTIMUNE-LUNG : INTEGRATIVE ANALYSIS OF THE TUMOR MICROENVIRONMENT AND OPTIMIZATION OF THE IMMUNOTHERAPY DURATION IN NON-SMALL CELL LUNG CANCER PATIENTS
Protocol code: IB 2019-07
Sponsor: Institut Bergonie (Hospital/Clinic/Other health care facility). Phase: Therapeutic exploratory (Phase II). Countries: France (ended).
Therapeutic area(s): Diseases [C] - Neoplasms [C04]
Gender: Female, Male. Age: 18-64 years, 65+ years. Enrolment: 80.
Status: Ended. Start date (EU): 2021-08-03. End date (EU): 2026-02-23. Decision date: 2024-06-24. Results received: No. Last updated: 2025-05-13.

Condition(s): Patients with locally advanced or metastasic Non-Small Cell Lung Carcinoma.
Product: CISPLATINE VIATRIS 25 mg/25 ml, solution à diluer pour perfusion, Tecentriq 1 200 mg concentrate for solution for infusion, CARBOPLATINE ACCORD 10 mg/ml, solution pour perfusion, Paclitaxel Accord Healthcare 6 mg/ml solution à diluer pour perfusion, KEYTRUDA 25 mg/mL concentrate for solution for infusion, ALIMTA 500 mg powder for concentrate for solution for infusion, OPDIVO 10 mg/mL concentrate for solution for infusion.

Primary endpoint: The primary endpoint is the 12-month progression-free rate (PFR) defined as the rate of patients in confirmed and unconfirmed complete reponse (CR and Cru), confirmed and unconfirmed partial response (PR and PRu) and stable disease (SD), as per RECIST v1.1, observed at 12 months (from randomization). To be considered as confirmed (i.e. as CR or PR), claimed responses will have to be confirmed 4 weeks later. Otherwise, responses will be considered as unconfirmed (CRu, PRu)., The 12-month PFR will be assessed, independently for each therapeutic strategy., Imaging will be centrally reviewed for all patients by an expert radiologist. Reviewed data will be used for the primary endpoint analysis.
Endpoint(s): Secondary endpoints will be assessed, independently for each therapeutic strategy:, The rate of patients who develop progression (as per RECIST v1.1) due to secondary resistance after obtaining a response to PD1/PDL-1 inhibition (secondary progression) will be assessed, independently for each therapeutic strategy, at 12 months from randomization, based on radiological centralized review., Duration of response (DoR) defined as the time interval between the first response (complete or partial response as per RECIST v1.1) to the time of the first documentation of disease progression., Progression-free survival (PFS) defined as the time interval between the date of randomization and the date of progression or death, whichever occurs first. Progression will be determined according to RECIST v1.1., Overall Survival (OS) defined as the time interval between the date of randomization and the date of death (of any cause)., Toxicity profile of each therapeutic strategy will be assessed during the study. Events will be graded according to the Common Terminology Criteria of Adverse Events (CTCAE) v5 from the NCI. AEs and SAEs will be coded according to MedDRA., Number of patients retreated by ICI will be described in Arm B. Similarly, for arm A-patients, number of patients treated by subsequent systemic therapy will be described., Biomarker study: integrated analysis of blood samples and tumor biopsies performed at randomization and progression to reveal markers of response and resistance.

Source: https://euclinicaltrials.eu/ctis-public/view/2023-509490-23-00